EU clinical trial 2024-519862-33-01: A Study of CUSP06 in Patients With Platinum-Refractory/Resistant Ovarian Cancer and Other Advanced Solid Tumors
Protocol code: CUSP06-1001
Sponsor: Oncusp Therapeutics Inc. (Pharmaceutical company). Phase: Human Pharmacology (Phase I)- First administration to humans. Countries: Denmark (authorised, recruitment pending), Spain (ongoing, recruiting).
Therapeutic area(s): Diseases [C] - Neoplasms [C04]
Gender: Female, Male. Age: 18-64 years, 65+ years. Enrolment: 30.
Start date (EU): 2026-05-18. Decision date: 2026-03-23. Results received: No. Last updated: 2026-07-08.
Decision dates by country: DK: 2026-03-23, ES: 2026-03-27

Condition(s): Platinum-resistant ovarian cancer (PROC), Advanced renal cell carcinoma (RCC), Other advanced CDH6-positive cancers

Source: https://euclinicaltrials.eu/ctis-public/view/2024-519862-33-01